EU clinical trial 2025-521424-30-00: A Phase 3 Mechanistic Longitudinal Study to Evaluate the Impact of EARLY Risankizumab Treatment on TRM Cell Levels in Moderate-to-Severe Psoriasis
Protocol code: B25-396
Sponsor: Icr Medical S.L. (Hospital/Clinic/Other health care facility). Phase: Therapeutic confirmatory (Phase III). Countries: Spain (authorised, recruitment pending).
Therapeutic area(s): Diseases [C] - Skin and Connective Tissue Diseases [C17]
Gender: Female, Male. Age: 18-64 years, 65+ years. Enrolment: 30.
Status: Authorised, recruitment pending. Decision date: 2025-08-12. Results received: No. Last updated: 2026-06-29.

Condition(s): Psoriasis
Product: ABBV-066

Primary endpoint: The change in the number of epidermal and dermal CD8+CD103+ TRM cells at week 16 (compared to baseline lesional levels) in moderate to severe psoriasis patients treated with per label doses of risankizumab in early versus late treatment.
Endpoint(s): 1. The percentage of patients with PASI 0 (complete clearance) at weeks 4, 16, 28, 40, and 52 in patients treated with per label doses of risankizumab in early versus late treatment. The percentage of patients with PASI ≤ 1 at weeks 4, 16, 28, 40, and 52 in patients treated with per label doses of risankizumab in early versus late treatment., 2. The change in the number of epidermal and dermal CD8+CD103+ TRM cells at week 16 (compared to baseline non-lesional levels) in psoriasis patients treated with per label doses of risankizumab in early versus late treatment. The change in the number of epidermal and dermal CD8+CD103+ TRM cells at week 52 (compared to baseline lesional and non-lesional levels) in psoriasis patients treated with per label doses of risankizumab in early versus late treatment., 3. Change of systemic inflammatory and CV associated biomarkers vs baseline levels at weeks 16 and 52 in early versus late treatment., 4. Safety events from week 0 to week 60 in patients receiving at least one dose of risankizumab.

Source: https://euclinicaltrials.eu/ctis-public/view/2025-521424-30-00